EU clinical trial 2024-516015-24-00: Prospective experimental study to evaluate the efficacy and tolerability of efgartigimod as an early treatment in patients with generalised myasthenia gravis.
Protocol code: HUB-MGEFG-001
Sponsor: Bellvitge University Hospital, Fundacio Institut D'Investigacio Biomedica De Bellvitge IDIBELL (Hospital/Clinic/Other health care facility, Laboratory/Research/Testing facility). Phase: Therapeutic use (Phase IV). Countries: Spain (ongoing, recruiting).
Therapeutic area(s): Diseases [C] - Nervous System Diseases [C10]
Gender: Female, Male. Age: 18-64 years, 65+ years. Enrolment: 20.
Status: Ongoing, recruiting. Start date (EU): 2025-04-07. Decision date: 2024-12-05. Results received: No. Last updated: 2024-12-05.

Condition(s): Patients affected by generalized myasthenia gravis
Product: Vyvgart 20 mg/mL concentrate for solution for infusion

Primary endpoint: Proportion of patients with MGg and anti-AChR antibody responders in MG-ADL after a full course of efgartigimod in combination with the usual prednisone initiation regimen.
Endpoint(s): Total score (per patient) and mean total score on the MG-ADL and mean change in the total score on the MG-ADL at weeks 4, 6, 8, 16 and 28, compared to the baseline score., Total score (per patient) and mean total QMG score and mean change in total QMG at weeks 4, 6, 8, 16 and 28, compared to baseline score., Proportion of responding patients in the QMG., Total score (per patient) and mean total MGC score and mean change in total MGC at weeks 4, 6, 8, 16 and 28, compared to baseline score., Proportion of responding patients in the MGC., Median time to onset of efficacy of efgartigimod, determined by when an improvement of 2 or more points on the MG-ADL scale is achieved., Median time of onset of efficacy of efgartigimod, determined by the time at which an improvement of 3 or more points on the QMG scale is achieved., Median time of onset of efficacy of efgartigimod, determined by the time at which an improvement of 3 or more points on the MGC scale is achieved., Proportion of early responders on the MG-ADL scale., Total score (per patient) and mean total score and mean change in total scores in the MG-QOL15r and in the EQ-5D-5L at weeks 4, 6, 8, 16 and 28, compared to the baseline score., Dose of steroids (prednisone) that patients are taking at 4, 6, 8, 16, and 28 weeks after starting treatment (day of first infusion of efgartigimod cycle/baseline visit)., Global levels of IgG, and of the different IgG subclasses, at the screening visit and at weeks 2, 4, 8, 16 and 28 after starting treatment (day of the first infusion of the efgartigimod cycle/baseline visit )., Levels of anti-AChR antibody titers at the screening visit and at weeks 2, 4, 6, 8, 16 and 28 after starting treatment (day of the first infusion of the efgartigimod cycle/baseline visit)., Number and percentage of patients receiving more than one cycle of efgartigimod., Number and percentage of patients receiving rescue treatment with IVIG and/or plasmapheresis., Number and percentage of patients requiring hospital admission (with description of the causes with number and percentage of them)., Number, percentage, description and severity of adverse events.

Source: https://euclinicaltrials.eu/ctis-public/view/2024-516015-24-00